EU clinical trial 2023-508968-30-00: Newly Diagnosed Adult Philadelphia Chromosome-Positive Acute Lymphoblastic Leukemia (Ph+ALL). Sequential Treatment with Ponatinib and the Bispecific Monoclonal Antibody Blinatumomab vs Chemotherapy and Imatinib. ALL2820
Protocol code: ALL2820
Sponsor: Fondazione Gimema Franco Mandelli Onlus (Health care). Phase: Therapeutic confirmatory (Phase III). Countries: Italy (ongoing, recruitment ended).
Therapeutic area(s): Diseases [C] - Hemic and Lymphatic Diseases [C15]
Gender: Female, Male. Age: 18-64 years, 65+ years. Enrolment: 236.
Status: Ongoing, recruitment ended. Start date (EU): 2021-09-08. Decision date: 2024-10-01. Results received: No. Last updated: 2026-06-16.

Condition(s): Adult Philadelphia Chromosome-Positive Acute Lymphoblastic Leukemia.
Product: CYCLOPHOSPHAMIDE, BLINCYTO 38.5 micrograms powder for concentrate and solution for solution for infusion, Idarubicina Sandoz 1 mg/ml concentrato per soluzione per infusione, CYTARABINE, METHOTREXATE, CYTARABINE, METHYLPREDNISOLONE SODIUM SUCCINATE, PREDNISONE, FILGRASTIM, CYTARABINE, METHOTREXATE, Glivec 100 mg hard capsules, Dexamethasone Phosphate 4 mg/ml Solution for Injection, PURINETHOL 50 mg compresse, Keppra 250 mg film-coated tablets, PREDNISONE, Melphalan 50 mg powder and solvent for solution for injection/infusion, METHYLPREDNISOLONE SODIUM SUCCINATE, Iclusig 15 mg film-coated tablets, LEDERFOLIN 25 mg Polvere per soluzione iniettabile per uso endovenoso, METHOTREXATE, Vincristine Sulfate 1 mg/ml solution for injection

Primary endpoint: The primary endpoint of this study is to evaluate the efficacy of a sequential approach based on the administration of Ponatinib plus and Blinatumomab vs chemotherapy combined with Imatinib, in terms of (EFS), a composite endpoint, with events defined as: non achievement of MRD negativity (CMR or PNQ), deaths for any reason, toxicity and resistance (due or not to an ABL1 mutation development) in adult Ph+ ALL (=18 years, no upper age limit).
Endpoint(s): The feasibility of patients’ stratification to allo-SCT allocation on the basis of a refined MRD evaluation and on the presence/absence of IKZF1-plus)., Capability of Blinatumomab to further reduce the MRD levels after Ponatinib induction., CMR or PNQ duration., DFS at 1 and 3 years., OS at 1 and 3 years., CIR., Safety profile. Safety profile in terms of incidence of grade =3 CTC-NCI side effects and toxicities., Comparison of patients’ quality of life (QoL) profiles over time by randomization arms.

Source: https://euclinicaltrials.eu/ctis-public/view/2023-508968-30-00